EU clinical trial 2024-511647-25-00: Comparative Bioavailability of Cabozantinib Film-Coated Tablets in Healthy Participants Under Fasting Conditions
Protocol code: BLCL-CAB-PIL01
Sponsor: Bluepharma Industria Farmaceutica S.A. (Pharmaceutical company). Phase: Human Pharmacology (Phase I)- Bioequivalence Study. Countries: Portugal (ended).
Therapeutic area(s): Not possible to specify
Gender: Female, Male. Age: 18-64 years. Enrolment: 15.
Status: Ended. Start date (EU): 2024-09-24. End date (EU): 2024-12-08. Decision date: 2024-09-13. Results received: No. Last updated: 2025-01-27.

Condition(s): No medical condition.

Source: https://euclinicaltrials.eu/ctis-public/view/2024-511647-25-00